EU clinical trial 2024-514680-26-00: A Multicenter, Randomized, Double-blind, Placebo-controlled, Flexible-dose Study of the Efficacy, Safety, and Tolerability of ITI-1284 in Patients with Agitation Associated with Alzheimer’s Dementia
Protocol code: ITI-1284-101
Sponsor: Intra-Cellular Therapies Inc. (Pharmaceutical company). Phase: Therapeutic exploratory (Phase II). Countries: Croatia (ongoing, recruiting), Romania (ongoing, recruiting), Spain (ongoing, recruiting), Slovakia (ongoing, recruiting), Czechia (ongoing, recruiting), Bulgaria (ongoing, recruiting).
Therapeutic area(s): Psychiatry and Psychology [F] - Psychological Phenomena [F02]
Gender: Female, Male. Age: 18-64 years, 65+ years. Enrolment: 137.
Status: Ongoing, recruiting. Start date (EU): 2025-07-17. Decision date: 2025-05-27. Results received: No. Last updated: 2026-05-19.
Decision dates by country: BG: 2025-05-30, HR: 2025-06-02, RO: 2025-06-02, ES: 2025-05-28, SK: 2025-05-27, CZ: 2025-05-28

Condition(s): Agitation Associated with Alzheimer’s Dementia
Product: ITI-1284, ITI-1284, Placebo tablets matching the ITI-1284 10 mg and 20 mg active tablets

Primary endpoint: The primary efficacy endpoint is the change from baseline to end of Week 12 in CMAI total score.
Endpoint(s): The key secondary efficacy endpoint: change from baseline to end of Week 12 in CGI-S score.

Source: https://euclinicaltrials.eu/ctis-public/view/2024-514680-26-00